EU clinical trial 2024-518177-33-00: A Phase 1/2 Trial of the Synthetic Cannabinoid ART27.13 in Patients with Cancer Anorexia and Weight Loss
Protocol code: ART27.13-100
Sponsor: Artelo Biosciences Limited (Pharmaceutical company). Phase: Phase I and Phase II (Integrated)- First administration to humans. Countries: Norway (ongoing, recruiting), Ireland (ongoing, recruiting).
Therapeutic area(s): Diseases [C] - Neoplasms [C04]
Gender: Female, Male. Age: 18-64 years, 65+ years. Enrolment: 14.
Status: Ongoing, recruiting. Start date (EU): 2021-10-01. Decision date: 2024-11-08. Results received: No. Last updated: 2025-05-12.
Decision dates by country: NO: 2024-11-11, IE: 2024-11-08

Condition(s): Cancer Anorexia
Product: ART27.13, Placebo, ART27.13

Primary endpoint: Change in lean body mass as determined by weight and DEXA scans at 4, 8, and 12 weeks., Change in anorexia as determined by a visual analog scale (VAS) and (FAACT) questionnaire., Change in KPS.
Endpoint(s): Safety: Assessment of the safety profile of ART27.13 by analyzing the type of, frequency, and severity of adverse drug effects as determined by reporting AEs and evaluation of routine chemistry and hematologic values, urinalyses, vital signs, and electrocardiograms., Quality of Life: Assess QoL using the Functional Assessment of Anorexia Cachexia Therapy (FAACT), the patientgenerated subjective global assessment (PG-SGA), the EORTC QLQ-C15-PAL, and revised Edmonton Symptom Assessment Scale (ESAS-r) questionnaires

Source: https://euclinicaltrials.eu/ctis-public/view/2024-518177-33-00